EU clinical trial 2024-519286-21-00: PHASE III STUDY WITH ATEZOLIZUMAB VERSUS PLACEBO IN MALIGNANT PLEURAL MESOTHELIOMA PATIENTS AFTER PLEURECTOMY/DECORTICATION
Sponsor: G.O.I.R.C. Gruppo Oncologico Italiano Di Ricerca Clinica (Patient organisation/association). Phase: Therapeutic confirmatory (Phase III). Countries: Italy (ongoing, recruiting).
Therapeutic area(s): Diseases [C] - Neoplasms [C04]
Gender: Female, Male. Age: 18-64 years, 65+ years. Enrolment: 90.
Status: Ongoing, recruiting. Start date (EU): 2024-12-17. Decision date: 2024-12-17. Results received: No. Last updated: 2025-08-13.

Condition(s): MALIGNANT PLEURAL MESOTHELIOMA PATIENTS
Product: ATEZOLIZUMAB, MPDL3280A Placebo

Primary endpoint: DFS, defined as the time from initiation of study treatment to first recurrence of disease or death for any cause, whichever occurs first. DFS will be calculated based on disease status evaluated by the investigator according to Response Evaluation Criteria in Solid Tumors, Version 1.1 (RECIST v1.1).
Endpoint(s): -Incidence, nature, frequency, duration, timing and severity of serious adverse events (SAEs) and non-serious adverse events (AEs) related to atezolizumab treatment graded by National Cancer Institute (NCI) Common Terminology Criteria for Adverse Events (CTCAE) v. 5. -OS, defined as the time from start of study drug to the date of death from any cause. -EQ-5D-3L questionnaire

Source: https://euclinicaltrials.eu/ctis-public/view/2024-519286-21-00